EU clinical trial 2024-517247-31-00: A Global Multicenter, Double-Blind, Randomized, Registrational Phase 3 Study of Lisaftoclax (APG-2575) in Combination with Azacitidine (AZA) in Patients with Newly Diagnosed Higher Risk Myelodysplastic Syndrome (HR-MDS) (GLORA-4)
Protocol code: APG2575MG301
Sponsor: Ascentage Pharma Group Inc. (Pharmaceutical company). Phase: Therapeutic confirmatory (Phase III). Countries: Poland (ongoing, recruiting), Italy (ongoing, recruiting), Greece (ongoing, recruiting), Czechia (ongoing, recruiting), Bulgaria (ongoing, recruiting), Hungary (ongoing, recruiting), Spain (ongoing, recruiting), France (ongoing, recruiting), Belgium (ongoing, recruiting), Germany (ongoing, recruiting), Finland (authorised, recruiting), Sweden (authorised, recruiting), Norway (authorised, recruitment pending).
Therapeutic area(s): Diseases [C] - Neoplasms [C04]
Gender: Female, Male. Age: 18-64 years, 65+ years. Enrolment: 382.
Start date (EU): 2025-07-07. Decision date: 2025-04-22. Results received: No. Last updated: 2026-07-22.
Decision dates by country: BE: 2025-04-24, FR: 2025-04-22, PL: 2025-04-27, GR: 2025-04-24, SE: 2026-02-20, NO: 2026-03-18, BG: 2025-04-28, DE: 2025-04-24, HU: 2025-04-28, ES: 2025-04-24, FI: 2026-05-27, IT: 2025-04-28, CZ: 2025-04-23

Condition(s): Newly Diagnosed Higher Risk Myelodysplastic Syndrome
Product: Azacitidine Seacross 25 mg/mL powder for suspension for injection, Lisaftoclax, Placebo (Lisaftoclax)

Primary endpoint: xxx, xxx
Endpoint(s): To compare the efficacy of xxx, To evaluate the safety of xxx, To evaluate the population pharmacokinetics (Pop PK) following treatment with xxx, To evaluate Health Economics Outcomes Research (HEOR) measures of lisaftoclax xxx based on EuroQol 5 Dimension (EQ-5D).

Source: https://euclinicaltrials.eu/ctis-public/view/2024-517247-31-00